EU clinical trial 2024-517725-93-00: A study to assess safety and tolerability, and explore efficacy of leniolisib for immune dysregulation in common variable immunodeficiency
Protocol code: LE 8201
Sponsor: Pharming Technologies B.V. (Pharmaceutical company). Phase: Therapeutic exploratory (Phase II). Countries: Spain (ended).
Therapeutic area(s): Diseases [C] - Immune System Diseases [C20]
Gender: Female, Male. Age: 0-17 years, 18-64 years, 65+ years. Enrolment: 6.
Status: Ended. Start date (EU): 2025-07-14. End date (EU): 2026-05-26. Decision date: 2025-05-26. Results received: No. Last updated: 2026-01-28.

Condition(s): Common variable immunodeficiency
Product: CDZ173/Leniolisib, CDZ173/Leniolisib, CDZ173/Leniolisib

Primary endpoint: Adverse events (AEs; via assessment of vital signs, safety labs, physical exams and overall trial safety monitoring)
Endpoint(s): Percent change from baseline in splenomegaly measured by 3D volume and 2D size of spleen, Percent change from baseline in lymphoproliferation measured as the SPD in the index lesions selected per the Cheson methodology, Percent change from baseline in lymphoproliferation measured as SPD of measurable non-index lesions selected as per the Cheson methodology, Hemoglobin over time, Platelet count over time, Absolute neutrophil count over time, Change in CT evidence of ILD evaluated using Hartmann scoring methodology, Change in pulmonary function testing, including forced expiratory volume 1 (FEV1), forced vital capacity (FVC), total lung capacity (TLC), residual volume (RV), diffusion capacity for carbon monoxide (DLCO), Absolute numbers and percentages of leukocyte populations (including lymphocyte subsets) over time, Percentages of naïve B cells and CD21low B cells over time, Percentage of T regulatory cells over time, Levels of CXCL13 over time, Levels of soluble IL-2Rα over time, Define the PK parameters for leniolisib in patients with CVID

Source: https://euclinicaltrials.eu/ctis-public/view/2024-517725-93-00